EU clinical trial 2024-510715-30-00: VEX-AZA: Treating VEXAS Syndrome with Azacitidine. A Single-Arm, Multicenter Phase II Study on the Efficacy and Safety of Azacitidine in Patients with VEXAS Syndrome
Sponsor: Rigshospitalet (Hospital/Clinic/Other health care facility). Phase: Therapeutic exploratory (Phase II). Countries: Denmark (ongoing, recruiting), Finland (ongoing, recruiting), Sweden (ongoing, recruiting), Norway (authorised, recruitment pending).
Therapeutic area(s): Diseases [C] - Hemic and Lymphatic Diseases [C15]
Gender: Female, Male. Age: 18-64 years, 65+ years. Enrolment: 50.
Start date (EU): 2024-09-26. Decision date: 2024-05-07. Results received: No. Last updated: 2026-07-24.
Decision dates by country: NO: 2026-03-23, DK: 2024-05-07, FI: 2025-05-30, SE: 2025-06-05

Condition(s): VEXAS
Product: AZACITIDINE

Primary endpoint: to assess the number and percentage of patients who experience a 50% relative reduction in VAF after completing six cycles of Azacitidine treatment.

Source: https://euclinicaltrials.eu/ctis-public/view/2024-510715-30-00